EU clinical trial 2024-516463-84-00: Randomised placebo controlled clinical trial of efficacy of MYOcardial protection in postacute inFLAMmatory cardiac involvEment due to COVID-19 (MYOFLAME-19)
Protocol code: MYOFLAME-19
Sponsor: Goethe University Frankfurt (Educational Institution). Phase: Therapeutic confirmatory (Phase III). Countries: Austria (ended), Germany (ended).
Therapeutic area(s): Diseases [C] - Virus Diseases [C02]
Gender: Female, Male. Age: 18-64 years, 65+ years. Enrolment: 280.
Status: Ended. Start date (EU): 2022-12-13. End date (EU): 2026-04-24. Decision date: 2024-10-18. Results received: No. Last updated: 2026-03-03.
Decision dates by country: AT: 2024-10-20, DE: 2024-10-18

Condition(s): Inflammatory cardiovascular involvement due to COVID-19, defined by Cardiovascular magnetic resonance imaging
Product: Prednisolon 5 mg JENAPHARM, Losartan-Kalium TAD® 25 mg Filmtabletten Wirkstoff: Losartan-Kalium, Prednisolon 10 mg JENAPHARM, Füllstoff DAC in hard gelatine capsules is used as placebo. Füllstoff DAC consists of mannitol 99.5 % and colloidal Silicon Dioxide 0.5 %, Losartan-Kalium TAD 12,5 mg Filmtabletten

Primary endpoint: The primary endpoint of this study is absolute LVEF change to baseline at W16, measured by CMR, compared between the verum and placebo group by absolute treatment difference
Endpoint(s): The secondary endpoints include the following continuous endpoints, where "changes" refer to the difference between baseline and W16 (BL, absolute and in %):, Mean Late gadolinium enhancement (LGE) extent (%) and change thereof compared to BL, CPET (achieved Work Rate, VO2max, VCO2 max, RER, AT, slope) and change thereof compared to BL, Mean T1 and T2 values (ms) and change thereof compared to BL, Mean LV and RV volumes (ml/m2) and LV mass (g/m2) as well as derived parameters and change thereof compared to BL, Mean Myocardial strain (%) and change thereof compared to BL, Mean Pulse wave velocity (m/s) and change thereof compared to BL, Aortic wall thickness (LGE, mm); and change thereof compared to BL, Average Symptom Score and change thereof compared to BL, Compliance: Frequency of prescribed medication consumed, participants diary and drug adherence, total cumulative steroid dose;, Tolerance: number of participants who required dose reduction or treatment cessation due to side effects, especially due to o Hypotension o Unblinding due to emergency safety issues, Number of Responders by achieving: o partial response: a normal CMR result is defined as normal T1 and T2, normal gender-age predicted LVEF, non-dilated LV o total response: in addition to the above absence of LGE, Proportion of participants with HF or MACE after 1 year, 1 year Event-free survival

Source: https://euclinicaltrials.eu/ctis-public/view/2024-516463-84-00